EU clinical trial 2024-519625-38-00: A randomized, parallel group, multi-center study of a fentanyl nasal spray compared with placebo nasal spray for postoperative pain management and prolonged open treatment over up to 120 hours postoperatively compared with intravenous patient-controlled analgesia using morphine
Protocol code: CWL15001
Sponsor: CCDRD Cooperative Clinical Drug Research and Development AG, 5med GmbH (Pharmaceutical company). Phase: Therapeutic confirmatory (Phase III). Countries: Germany (ended), Bulgaria (ended).
Therapeutic area(s): Diseases [C] - Pathological Conditions, Signs and Symptoms [C23]
Gender: Female, Male. Age: 18-64 years, 65+ years. Enrolment: 160.
Status: Ended. Start date (EU): 2024-04-14. End date (EU): 2025-10-10. Decision date: 2025-01-28. Results received: No. Last updated: 2026-01-27.
Decision dates by country: BG: 2025-01-28, DE: 2025-02-06

Condition(s): Postoperative pain relief
Product: Morphin-hameln 100 mg Injektionslösung, Fentanyl Nasal Spray, Fentanyl Nasal Spray Placebo

Primary endpoint: Survival distribution in the period from start of treatment with the first dose of the study medication until terminating the trial due to inadequate analgesia as required by the patient or felt necessary by the investigator within the first 24 hours after start of treatment with non-terminating patients censored at 24 hours.
Endpoint(s): sum of ratings of pain intensity on a 11-point numeric rating scale at pre-defined points in time: at hours 1, 2, 3, 4, 6, 8, 12, 16, 20, and 24 after start of treatment (TotPaR), sum of pain intensity difference ratings on a 11-point numeric rating scale comparing the pain rating before start of treatment (0) and ratings at pre-defined points in time (SPID): at hours 1, 2, 3, 4, 6, 8, 12, 16, 20, 24, 36, 48, 60, 72, 84, 96, 108, and 120 after start of treatment (Patients will not be woken up for a postoperative measurement. The last observation carried forward method will be used to replace a missing value, percentage of patients who terminate the study due to inadequate analgesia during the 24-hours treatment period, percentage of patients who terminate the study due to any reason during the 24-hours treatment period, number of actuations administered, number of unsuccessful actuations during lock-out period, patient's rating of usability [System Usability Scale (SUS)], patient’s global rating of efficacy using a four-point Likert scale (poor, fair, good, or excellent), investigator's global rating of efficacy (Likert scale: see above), evaluation of ease of care (patients, nursing staff, and physiotherapists)

Source: https://euclinicaltrials.eu/ctis-public/view/2024-519625-38-00